EU clinical trial 2023-504152-97-00: Phase 3, Multicenter, Randomized, Double-Blind, Placebo-Controlled Study to Evaluate the Efficacy, Safety, Pharmacokinetics, and Pharmacodynamics of Nipocalimab Administered to Adults with Generalized Myasthenia Gravis
Protocol code: MOM-M281-011
Sponsor: Janssen - Cilag International (Pharmaceutical company). Phase: Therapeutic confirmatory (Phase III). Countries: Belgium (ongoing, recruiting), Czechia (ongoing, recruiting), Sweden (ongoing, recruiting), Denmark (ended), Spain (ongoing, recruiting), Germany (ongoing, recruiting), France (ongoing, recruiting), Poland (ongoing, recruiting), Italy (ongoing, recruiting).
Therapeutic area(s): Diseases [C] - Immune System Diseases [C20]
Gender: Female, Male. Age: 18-64 years, 65+ years. Enrolment: 149.
Start date (EU): 2021-11-26. Decision date: 2023-09-11. Results received: No. Last updated: 2026-06-04.
Decision dates by country: DK: 2023-09-11, IT: 2023-09-18, SE: 2023-09-12, BE: 2023-09-11, ES: 2023-09-11, DE: 2023-09-15, CZ: 2023-09-11, PL: 2023-09-19, FR: 2023-09-15

Condition(s): Generalized Myasthenia Gravis
Product: JNJ-80202135, JNJ-80202135, JNJ-80202135, Saline (placebo) is being used in accordance with the terms of its marketing authorization.

Primary endpoint: Average change from baseline (screening and Day 1) in MG-ADL total score over Weeks 22, 23 and 24. Sub study: Percent change in total IgG levels from pre-first nipocalimab dose Day 1 to Week 8 (Day 57)

Source: https://euclinicaltrials.eu/ctis-public/view/2023-504152-97-00